EU clinical trial 2024-515970-28-00: Factors Determining the Efficacy of Botulinum Toxin for Arm Tremor in Dystonia: An Exploratory Study
Protocol code: 115083
Sponsor: Stichting Radboud universitair medisch centrum (Hospital/Clinic/Other health care facility). Phase: Therapeutic use (Phase IV). Countries: Netherlands (ongoing, recruiting).
Therapeutic area(s): Diseases [C] - Nervous System Diseases [C10]
Gender: Female, Male. Age: 18-64 years, 65+ years. Enrolment: 60.
Status: Ongoing, recruiting. Start date (EU): 2024-12-20. Decision date: 2024-11-11. Results received: No. Last updated: 2024-11-11.

Condition(s): Dystonic tremor syndrome
Product: Dysport 300 E, poeder voor oplossing voor injectie

Primary endpoint: The associations between clinical (e.g. dystonic tremor versus tremor associated with dystonia, jerkiness, dominant tremor pattern, sensory trick), electrophysiological (e.g. frequency-width at half-width power, intermuscular coherence), ultrasonographic (e.g. echogenicity, muscle thickness, tremulous muscles) and (functional) magnetic resonance imaging tremor characteristics (e.g. ratio of tremor-related activity in the basal ganglia versus cerebello-thalamo-cortical circuit)
Endpoint(s): The clinical, electrophysiological, ultrasonographic and (functional) magnetic resonance imaging differences between dystonic tremor and tremor associated with dystonia at baseline (e.g. jerkiness, dominant tremor pattern, frequency-width at half-width power, intermuscular coherence, tremulous muscles, ratio of tremor-related activity in the basal ganglia versus cerebello-thalamo-cortical circuit)., The agreement between a clinical assessment, polymyography and muscle ultrasound on muscle selection

Source: https://euclinicaltrials.eu/ctis-public/view/2024-515970-28-00